EU clinical trial 2022-500044-38-01: A Parallel-group (2-Arm), Randomized, Double-blind, 12-week Trial to Evaluate the Efficacy and Safety of MC2-25 Cream and MC2-25 Vehicle in Subjects with Chronic Kidney Disease-associated Pruritus (CKD-aP)
Protocol code: MC2-25-C1 /ITCHINESS
Sponsor: Mc2 Therapeutics Limited (Pharmaceutical company). Phase: Therapeutic exploratory (Phase II). Countries: Hungary (ended), Germany (ended), Poland (ended).
Therapeutic area(s): Diseases [C] - Skin and Connective Tissue Diseases [C17]
Gender: Female, Male. Age: 18-64 years, 65+ years. Enrolment: 48.
Status: Ended. Start date (EU): 2023-02-20. End date (EU): 2024-02-02. End date: 2024-02-08. Decision date: 2023-01-16. Results received: Yes. Last updated: 2023-08-28.
Decision dates by country: DE: 2023-01-16, PL: 2023-01-19, HU: 2023-01-17

Condition(s): Chronic Kidney Disease associated Pruritus
Product: Placebo equals test product, except active substance. Active substance is not contained in placebo

Primary endpoint: Mean change in weakly mean WI-NRS recorded in the subject’s diary from Baseline to Week 12 for MC2-25 cream compared to MC2-25 vehicle.
Endpoint(s): Percentage of subjects obtaining a ≥4-point improvement in weekly mean WI-NRS recorded in the subject’s diary from Baseline to Week 12 for MC2-25 cream compared to MC2-25 vehicle., Percentage of subjects obtaining a ≥3-point improvement in weekly mean WI-NRS recorded in the subject’s diary from Baseline to Week 12 for MC2-25 cream compared to MC2-25 vehicle., Percentage of subjects obtaining a complete response in weekly mean WI-NRS recorded in the subject’s diary from Baseline to Week 12 for MC2-25 cream compared to MC2-25 vehicle.

Source: https://euclinicaltrials.eu/ctis-public/view/2022-500044-38-01